EU clinical trial 2024-511520-13-00: Gene Therapy for Pyruvate Kinase Deficiency (PKD): A Phase I Clinical Trial to Evaluate the Safety of the Infusion of Autologous CD34+ Cells Transduced with a Lentiviral Vector Carrying the Codon Optimized Red Cell Pyruvate Kinase (coRPK) Gene in Adult and Pediatric Subjects with PKD
Protocol code: RP-L301-0119
Sponsor: Rocket Pharmaceuticals Inc. (Pharmaceutical company). Phase: Human Pharmacology (Phase I)- Other. Countries: Spain (ended).
Therapeutic area(s): Diseases [C] - Hemic and Lymphatic Diseases [C15]
Gender: Female, Male. Age: 0-17 years, 18-64 years. Enrolment: 3.
Status: Ended. Start date (EU): 2019-11-04. End date (EU): 2025-06-09. End date: 2025-06-10. Decision date: 2024-08-22. Results received: Yes. Last updated: 2025-05-05.

Condition(s): Inherited metabolic disorder of the enzyme pyruvate kinase which affects the survival of red blood cells, Pyruvate Kinase Deficiency
Product: Busulfan Fresenius Kabi 6 mg/ml concentrate for solution for infusion, Neupogen 30 MU (0,6 mg/ml) solución inyectable en jeringa precargada filgrastim, Mozobil 20 mg/ml solution for injection, Merilen

Primary endpoint: 1.Insertional mutagenesis:Evaluation of gene-modified clonal repertoire and lentiviral ISA in blood and, if feasible, BM cells via modified gene sequencing (MGS)-PCR. 2.RCL (as required and in settings where there is clinical suspicion of unexplained viral illness) in blood. 3. Immunogenicity: Evidence of antibodies against coRPK (or other LV components) in blood (serum)
Endpoint(s): *Achievement of stem cell engraftment ≤42 days after infusion. Neutrophil engraftment is defined as the first of three consecutive days with an absolute neutrophil count ≥500/μL. Platelet engrafment is defined as the first of three consecutive days with a platelet count ≥ 20,000/μL in the absence of thrombopoietin mimetics and independent of platelet transfusions for at least 7 days. *Time to stem cell engraftment. *Incidence of respiratory complications

Source: https://euclinicaltrials.eu/ctis-public/view/2024-511520-13-00